EU clinical trial 2023-509432-25-00: STS-001: An explorative clinical study to assess the potential of intravenously administered sodium thiosulfate in subjects with primary Raynaud’s phenomenon
Protocol code: STS-001
Sponsor: Universitair Medisch Centrum Groningen (Hospital/Clinic/Other health care facility). Phase: Therapeutic exploratory (Phase II). Countries: Netherlands (ongoing, recruitment ended).
Therapeutic area(s): Diseases [C] - Cardiovascular Diseases [C14]
Gender: Female, Male. Age: 18-64 years. Enrolment: 12.
Status: Ongoing, recruitment ended. Start date (EU): 2025-10-24. Decision date: 2025-09-18. Results received: No. Last updated: 2025-12-19.

Condition(s): Raynaud’s phenomenon
Product: Natriumthiosulfat 25%

Primary endpoint: For each treatment:area under the cooling and rewarming curve (AUC) and mean ischemic time of one hand assessed by cooling and recovery photo-electric plethysmography (PPG, BIOPAC), For each treatment: regions of interest peripheral blood perfusion of same hand by FLIR thermography system (FLIR E53)
Endpoint(s): Pharmacokinetics: Determination and comparison of AUC0-t, AUC0-inf Cmax after increasing dose regimens of intravenously administered STS, Pharmacokinetics: Determination and comparison of steady-state levels after increasing dose regimens of intravenously administered STS, Pharmacokinetics: Determination and comparison of elimination PK parameters after increasing dose regimens of intravenously administered STS, Pharmacokinetics: Determination of endogenous STS levels (based on various pre-dose levels) in Raynaud’s patients, Safety and tolerability as evidenced by: Incidence of treatment-emergent adverse events (TEAEs), Safety and tolerability as evidenced by: ECG, Safety and tolerability as evidenced by: Continuous blood pressure measurement (Finapress), Safety and tolerability as evidenced by: Local tolerability at vein of intravenous administration, Pharmacodynamics: Oxidative stress (systemic free thiols, plasma malondialdehyde (MDA)), Pharmacodynamics: Inflammation (circulating pro-inflammatory cytokines e.g. IL-6, IL-1 beta and TNFalpha), Pharmacodynamics: Endothelial activation (circulating adhesion molecules)

Source: https://euclinicaltrials.eu/ctis-public/view/2023-509432-25-00